EU clinical trial 2025-521454-42-00: Pilot randomized controlled trial of the prevention of early respiratory tract infections in intubated patients. Comparison of the safety and efficacy of a short course of systemic antibiotic, a cough simulator and aspiration of subglottic secretions
Protocol code: PIRAMIDES (24/096-E)
Sponsor: Hospital Clinico San Carlos (Hospital/Clinic/Other health care facility). Phase: Therapeutic use (Phase IV). Countries: Spain (authorised, recruitment pending).
Therapeutic area(s): Diseases [C] - Respiratory Tract Diseases [C08]; Health Care [N] - Health Care Quality, Access, and Evaluation [N05]; Diseases [C] - Bacterial Infections and Mycoses [C01]
Gender: Female, Male. Age: 18-64 years, 65+ years. Enrolment: 60.
Status: Authorised, recruitment pending. Decision date: 2025-05-21. Results received: No. Last updated: 2026-07-09.

Condition(s): Reduced level of consciousness associated with severe trauma, traumatic brain injury, stroke, cardiac arrest or other causes.
Product: CEFTRIAXONA SALA 1 g Polvo para solución inyectable y para perfusión EFG

Primary endpoint: Incidence of device (cough simulator and subglottic aspiration equipment), antibiotic and infection-related severe adverse events from inclusion to day 14, Incidence of respiratory tract infections (pneumonia and tracheobronchitis) in intubated critically ill patients from inclusion to day 14
Endpoint(s): Duration of intubation (days with endotracheal tube plus tracheostomy canula) at 90 days, Total days of respiratory support (expressed as days without invasive and non-invasive mechanical ventilation or high-flow nasal canula) at 90 days, Days of ICU-stay, Points of the modified Rankin score on day 90, Day 90 mortality, Days without receiving systemic antibiotic therapy on day 14, Percentage of positive bacterial cultures of respiratory samples during first 14 days, Type of bacterial isolates (Gram-negatives/positives, community/nosocomial) in respiratory samples at day 14, Bacterial resistance mechanisms identified in cultures (extended-spectrum betalactamases, carbapenemases and methicillin, vancomycin, linezolid resistance) in respiratory or any other location until day 14.), Percentage of subjects with bood-stained respiratory secretions, Number of daily catheter secretion suctioning sessions until day 14

Source: https://euclinicaltrials.eu/ctis-public/view/2025-521454-42-00